EU clinical trial 2025-522309-40-00: A Phase 2, Multicenter, Randomized, Placebo-Controlled, Double-Blind, Dose-Ranging Trial to Evaluate the Efficacy and Safety of Zasocitinib in Participants with Nonsegmental Vitiligo.
Protocol code: TAK-279-VT-2001
Sponsor: Takeda Development Center Americas Inc. (Pharmaceutical company). Phase: Therapeutic exploratory (Phase II). Countries: Poland (ongoing, recruiting), Italy (ongoing, recruiting), Spain (ongoing, recruiting), France (ongoing, recruiting).
Therapeutic area(s): Diseases [C] - Skin and Connective Tissue Diseases [C17]
Gender: Female, Male. Age: 18-64 years, 65+ years. Enrolment: 151.
Status: Ongoing, recruiting. Start date (EU): 2026-02-11. Decision date: 2025-12-19. Results received: No. Last updated: 2026-06-22.
Decision dates by country: IT: 2025-12-22, FR: 2025-12-19, ES: 2026-01-13, PL: 2026-01-04

Condition(s): Non-segmental vitiligo
Product: ZASOCITINIB, ZASOCITINIB, White opaque, hard hypromellose capsule, size 3 containing same excipients as TAK-279 active capsule

Primary endpoint: Proportion of participants achieving ≥75% improvement from baseline in F-VASI at Week 24.
Endpoint(s): Percent change from baseline in the F-VASI at Week 24, Percent change from baseline in the T-VASI at Week 24, Proportion of participants achieving ≥50% improvement from baseline in F-VASI at Week 24, Proportion of participants achieving ≥50% improvement from baseline in T-VASI at Week 24

Source: https://euclinicaltrials.eu/ctis-public/view/2025-522309-40-00